EU clinical trial 2024-515398-90-01: SAFE study
Sponsor: Stichting Amsterdam UMC (Hospital/Clinic/Other health care facility). Phase: Therapeutic confirmatory (Phase III). Countries: Netherlands (ongoing, recruitment ended).
Therapeutic area(s): Diseases [C] - Bacterial Infections and Mycoses [C01]
Gender: Female, Male. Age: 18-64 years, 65+ years. Enrolment: 300.
Status: Ongoing, recruitment ended. Start date (EU): 2020-08-17. Decision date: 2024-08-14. Results received: No. Last updated: 2026-01-30.

Condition(s): Staphylococcus aureus bacteremia
Product: Clindamycin 600 mg Capsules, hard, CEFAZOLINE LDP-LABORATORIOS TORLAN 2 g, poudre pour solution injectable/pour perfusion, Flucloxacillin 250mg Powder for Solution for Injection or Infusion

Primary endpoint: The primary outcome is success of therapy, defined at 180 days after randomization by presence of the following: 1. Patient alive. 2. No evidence of microbiologically confirmed disease relapse, defined as symptoms and/or signs of infection, after initial clinical improvement, with S. aureus isolated from blood or another normally sterile site (e.g. joint fluid, tissue) by conventional culture.

Source: https://euclinicaltrials.eu/ctis-public/view/2024-515398-90-01